EU clinical trial 2023-505245-13-00: Molecular signatures associated with response to ICS treatment in patients with COPD stratified by eosinophil levels
Protocol code: 3TR-ICS-COPD
Sponsor: Fundacio De Recerca Clinic Barcelona-Institut D’investigacions Biomediques August Pi I Sunyer (Laboratory/Research/Testing facility). Phase: Therapeutic use (Phase IV). Countries: Germany (ongoing, recruiting), Spain (ongoing, recruiting), Netherlands (ongoing, recruiting).
Therapeutic area(s): Diseases [C] - Respiratory Tract Diseases [C08]
Gender: Female, Male. Age: 18-64 years. Enrolment: 60.
Status: Ongoing, recruiting. Start date (EU): 2025-02-12. Decision date: 2024-07-16. Results received: No. Last updated: 2026-01-11.
Decision dates by country: DE: 2024-07-18, ES: 2024-07-16, NL: 2024-07-17

Condition(s): Chronic obstructive pulmonary disease (COPD)
Product: BUDESONIDE

Primary endpoint: Significant molecular changes (p<0.05, and/or FDR<0.05) (e.g. microbiome and/or transcriptome and/or proteins and/or epigenetics) in sputum, nasal and oropharyngeal swabs, urine and/or blood associated with ICS treatment vs. no ICS treatment (usual care), in COPD stratified by their blood eosinophil counts. The changes will be calculated as variations from Visit 2 to Visit 3 (8 weeks).
Endpoint(s): Significant molecular changes (p<0.05, and/or FDR<0.05) (e.g. microbiome and/or transcriptome and/or proteins and/or epigenetics) in sputum, nasal and oropharyngeal swabs, urine and/or blood associated with ICS treatment vs. no ICS treatment (usual care), in COPD with different airflow limitation severities. The molecular changes will be calculated as variations from Visit 2 to Visit 3.

Source: https://euclinicaltrials.eu/ctis-public/view/2023-505245-13-00